EU clinical trial 2024-519903-88-00: A Phase II, randomised, double-blind, placebo-controlled trial to evaluate the efficacy and safety of oral controlled-ileal-release nicotinic acid (CIR-NA) for inducing remission in subjects with prediabetes
Protocol code: CONCEPT
Sponsor: Universitaetsklinikum Schleswig-Holstein AöR (Hospital/Clinic/Other health care facility). Phase: Therapeutic exploratory (Phase II). Countries: Germany (ongoing, recruiting).
Therapeutic area(s): Diseases [C] - Nutritional and Metabolic Diseases [C18]
Gender: Female, Male. Age: 18-64 years, 65+ years. Enrolment: 390.
Status: Ongoing, recruiting. Start date (EU): 2026-03-03. Decision date: 2025-08-19. Results received: No. Last updated: 2026-07-23.

Condition(s): Prediabetes
Product: CIR-NA (controlled-ileal-release nicotinic acid), Placebo CIR-NA

Primary endpoint: Remission of prediabetes at week 26
Endpoint(s): Progression of prediabetes to type 2 diabetes mellitus at week 26, Fasting plasma glucose levels at week 26, Glycated haemoglobin (HbA1c) levels at week 26, 2-h oral Glucose Tolerance Test levels at week 26

Source: https://euclinicaltrials.eu/ctis-public/view/2024-519903-88-00